EU clinical trial 2024-517858-10-00: A Phase II Randomized Controlled Trial of Neoadjuvant Pembrolizumab with Radiotherapy and Adjuvant Pembrolizumab in Patients with High-Risk, Localized Soft Tissue Sarcoma of the Extremity
Protocol code: SU2C-SARC032
Sponsor: Fondazione IRCCS Istituto Nazionale Dei Tumori, Sarcoma Alliance for Research through Collaboration (Hospital/Clinic/Other health care facility, Health care). Phase: Therapeutic exploratory (Phase II). Countries: Italy (ongoing, recruiting).
Therapeutic area(s): Diseases [C] - Neoplasms [C04]; Diseases [C] - Musculoskeletal Diseases [C05]; Diseases [C] - Skin and Connective Tissue Diseases [C17]
Gender: Female, Male. Age: 18-64 years, 65+ years. Enrolment: 20.
Status: Ongoing, recruiting. Start date (EU): 2019-12-11. Decision date: 2024-11-05. Results received: No. Last updated: 2024-11-05.

Condition(s): high-risk soft tissue sarcoma of the extremity (undifferentiated pleomorphic sarcoma or dedifferentiated/pleomorphic liposarcoma, tumor size > 5 cm, grade 2 or 3 out of 3)
Product: KEYTRUDA 25 mg/mL concentrate for solution for infusion

Primary endpoint: Disease-free survival will be the primary efficacy endpoint. Disease recurrence is defined as clinically diagnosed or biopsy-confirmed recurrent sarcoma at a site distant to the primary tumor, including nodal metastasis, loco-regional recurrence, and death without documented recurrence.
Endpoint(s): 1. To evaluate the loco-regional recurrence-free survival (RFS), the distant disease free survival, and overall survival (OS) in both patient cohorts. 2. To test the safety of neoadjuvant pembrolizumab administered with conventionally fractionated radiotherapy targeting soft tissue sarcoma of the extremity

Source: https://euclinicaltrials.eu/ctis-public/view/2024-517858-10-00